EU clinical trial 2024-511330-13-00: A Randomized Double-blind, Four-Arm Active and Placebo-controlled Dose-Finding Trial to Evaluate the Efficacy, Tolerability, Safety and Dose Response of LYT-100 in Patients with Idiopathic Pulmonary Fibrosis (IPF).
Protocol code: LYT-100-2022-204
Sponsor: Puretech Lyt 100 Inc. (Pharmaceutical company). Phase: Therapeutic exploratory (Phase II). Countries: Romania (ongoing, recruitment ended), Greece (ongoing, recruitment ended).
Therapeutic area(s): Diseases [C] - Respiratory Tract Diseases [C08]
Gender: Female, Male. Age: 18-64 years, 65+ years. Enrolment: 14.
Status: Ongoing, recruitment ended. Start date (EU): 2023-01-17. Decision date: 2024-05-17. Results received: No. Last updated: 2026-07-01.
Decision dates by country: GR: 2024-07-15, RO: 2024-05-17

Condition(s): Idiopathic Pulmonary Fibrosis
Product: Placebo to match lyt-100 and pirfenidone capsules, PIRFENIDONE, Deupirfenidone (LYT-100), Deupirfenidone (LYT-100)

Primary endpoint: Rate of decline in FVC (in mL) over Part A (26 weeks)
Endpoint(s): Rate of decline in FVC % predicted (FVCpp) over Part A (Week 26), Time to IPF progression through 26 weeks (the end of Part A), as defined by a decline from baseline in FVCpp of 5% or greater, or death, Time to hospitalization due to respiratory cause (as determined by the investigator) or all cause mortality through 26 weeks, Time to hospitalization due to respiratory cause (as determined by the investigator) through 26 weeks, Time to all-cause mortality through 26 weeks, Change from baseline to Week 26 in King's Brief Interstitial Lung Disease Questionnaire (K-BILD) total score, Change from baseline to Week 26 in St. George’s Respiratory Questionnaire – IPF Version (SGRQ-I), Change from baseline to Week 26 in EuroQol 5-Dimensional Quality of Life Questionnaire (EQ-5D), Change in serum biomarkers from baseline through Week 26, Number and duration of respiratory hospitalizations or pulmonary exacerbations (as determined by the investigator) through 26 weeks, Rate of hospitalization due to respiratory cause (as determined by the investigator) through 26 weeks, Part B: Rate of decline in FVCpp from the end of Part A (Week 26) to the end of Part B Period 1 (Week 52) Change in FVCpp from the end of Part A (Week 26) to the end of Part B Period 1 (Week 52), Part B: Rate of decline in FVC (in mL) from the end of Part A (Week 26) to the end of Part B Period 1 (Week 52) using the values obtained from spirometry assessments, Part B: Time to IPF progression in Part B, as defined by a decline from the end of Part A (Week 26) to the end of Part B Period 1 (Week 52) in FVCpp of 5% or greater, or death, Part B: Time to hospitalization due to respiratory cause (as determined by the investigator) from the start of Part B (Week 26) through the end of Part B Period 1 (Week 52), Part B: Time to all-cause mortality from the start of Part B (Week 26) through the end of Part B Period 1 (Week 52), Part B: Time to hospitalization due to respiratory cause (as determined by the investigator) or all-cause mortality from the start of Part B (Week 26) through the end of Part B Period 1 (Week 52), Part B: Total duration on assigned dose from the start of Part B through the end of Part B Period 1 (Week 52), Part B: Change in EQ-5D from the end of Part A (Week 26) through the end of Part B Period 1 (Week 52), Part B: Change in serum and plasma biomarkers from the end of Part A (Week 26) through the end of Part B Period 1 (Week 52), Part B: Number and duration of respiratory hospitalizations or pulmonary exacerbations(as determined by the investigator) from the start of Part B (Week 26) through the end of Part B Period 1 (Week 52), Part B: Rate of hospitalization due to respiratory cause (as determined by the investigator) from the start of Part B (Week 26) through the end of Part B Period 1 (Week 52)

Source: https://euclinicaltrials.eu/ctis-public/view/2024-511330-13-00